EU clinical trial 2024-514942-35-00: "A study to test how well BI 3000202 is tolerated by people with type 1 interferonopathies"
Protocol code: 1509-0003
Sponsor: Boehringer Ingelheim International GmbH, Boehringer Ingelheim Espana S.A. (Pharmaceutical company). Phase: Human Pharmacology (Phase I)- Other. Countries: Germany (ongoing, recruitment ended), Portugal (ongoing, recruitment ended), Italy (ongoing, recruitment ended), Spain (ongoing, recruitment ended), France (ongoing, recruitment ended), Belgium (ongoing, recruitment ended).
Therapeutic area(s): Diseases [C] - Immune System Diseases [C20]
Gender: Female, Male. Age: 18-64 years, 65+ years. Enrolment: 9.
Status: Ongoing, recruitment ended. Start date (EU): 2025-04-11. Decision date: 2025-03-07. Results received: No. Last updated: 2026-01-07.
Decision dates by country: ES: 2025-03-11, PT: 2025-03-07, IT: 2025-03-11, FR: 2025-03-07, BE: 2025-11-20, DE: 2025-03-07

Condition(s): Type 1 interferonopathies

Source: https://euclinicaltrials.eu/ctis-public/view/2024-514942-35-00